EU clinical trial 2024-512015-47-00: A Phase 3 Randomized, Open-Label Clinical Study to Evaluate the Efficacy and Safety of Pembrolizumab plus Epacadostat, Pembrolizumab Monotherapy, and the EXTREME Regimen as First line Treatment for Recurrent or Metastatic Head and Neck Squamous Cell Carcinoma (KEYNOTE-669/ECHO-304)
Protocol code: MK-3475-669
Sponsor: Incyte Corp. (Pharmaceutical company). Phase: Therapeutic confirmatory (Phase III). Countries: Portugal (ended), Spain (ended).
Therapeutic area(s): Diseases [C] - Neoplasms [C04]
Gender: Female, Male. Age: 18-64 years, 65+ years. Enrolment: 42.
Status: Ended. Start date (EU): 2018-01-09. End date (EU): 2025-10-30. End date: 2025-10-31. Decision date: 2024-06-11. Results received: No. Last updated: 2025-03-18.
Decision dates by country: ES: 2024-06-12, PT: 2024-06-11

Condition(s): Histologically or cytologically-confirmed Recurrent or Metastatic Head and Neck Squamous Cell Carcinoma that is considered incurable by local therapies
Product: KEYTRUDA 25 mg/mL concentrate for solution for infusion, KEYTRUDA 25 mg/mL concentrate for solution for infusion, KEYTRUDA 25 mg/mL concentrate for solution for infusion, Epacadostat, CETUXIMAB, Epacadostat, CISPLATIN, KEYTRUDA 25 mg/mL concentrate for solution for infusion, CARBOPLATIN, FLUOROURACIL

Primary endpoint: Objective Response Rate (ORR) of Pembrolizumab + Epacadostat, Pembrolizumab Monotherapy and the EXTREME Regimen
Endpoint(s): Safety and Tolerability of Pembrolizumab + Epacadostat Versus Pembrolizumab Versus the EXTREME Regimen as Measured by Number of Participants Experiencing Adverse Events (AEs), Safety and Tolerability of Pembrolizumab + Epacadostat Versus Pembrolizumab Versus the EXTREME Regimen as Measured by Number of Participants Discontinuing Study Treatment Due to AEs

Source: https://euclinicaltrials.eu/ctis-public/view/2024-512015-47-00